EU clinical trial 2024-512822-28-00: A Phase 1, Open-Label, Multicenter Study of INCB123667 as Monotherapy and in Combination With Anticancer Therapies in Participants With Selected Advanced Solid Tumors
Protocol code: INCB 123667-101
Sponsor: Incyte Corp. (Pharmaceutical company). Phase: Human Pharmacology (Phase I)- First administration to humans. Countries: France (ongoing, recruiting), Italy (ongoing, recruiting), Netherlands (ended).
Therapeutic area(s): Diseases [C] - Neoplasms [C04]
Gender: Female, Male. Age: 18-64 years, 65+ years. Enrolment: 235.
Start date (EU): 2022-08-08. Decision date: 2024-06-21. Results received: No. Last updated: 2026-06-09.
Decision dates by country: NL: 2024-06-21, FR: 2024-06-25, IT: 2024-09-09

Condition(s): Advanced or metastatic solid tumors

Source: https://euclinicaltrials.eu/ctis-public/view/2024-512822-28-00